EU clinical trial 2024-513004-33-00: Proof-of-concept Phase II study to evaluate the efficacy and safety of prednisone in the treatment of idiosyncratic hepatotoxicity and its mechanistic pathways through an integrative analysis: the DILICORT clinical trial
Protocol code: DILICORT-2024
Sponsor: Fundacion Publica Andaluza Para La Investigacion De Malaga En Biomedicina Y Salud (Laboratory/Research/Testing facility). Phase: Therapeutic exploratory (Phase II). Countries: Spain (ongoing, recruiting).
Therapeutic area(s): Diseases [C] - Digestive System Diseases [C06]
Gender: Female, Male. Age: 18-64 years, 65+ years. Enrolment: 60.
Status: Ongoing, recruiting. Start date (EU): 2025-01-14. Decision date: 2024-07-15. Results received: No. Last updated: 2025-10-14.

Condition(s): Hepatotoxicity
Product: Decortin 5 mg tablete, MICROCRYSTALLINE CELLULOSE

Primary endpoint: The proportion of patients that achieve a decrease of at least 50% of the peak value in TBL at day 14., Time (days) to TBL value return to normal., Proportion of AEs, SAEs, fatality, and proportion of patients with premature termination due to AEs.
Endpoint(s): The proportion of patients that achieve a decrease of at least 50% of the peak value in ALT, AST and INR at day 7., Time (days) for the ALT, AST and INR values return to normal., Proportion of patients that develop acute liver failure, need for liver transplantation or liver related death at day 28., Score changes in SF-36 quality of life validated questionnaire performed at visit 1 (day 1, start of treatment) and at visit 6 (day 35, end of treatment).

Source: https://euclinicaltrials.eu/ctis-public/view/2024-513004-33-00